EU clinical trial 2024-513563-75-00: Trial to assess the safety and antitumor activity of GEN1057 on malignant solid tumors
Protocol code: GCT1057-01
Sponsor: Genmab A/S (Pharmaceutical company). Phase: Human Pharmacology (Phase I)- First administration to humans. Countries: Spain (ended).
Therapeutic area(s): Diseases [C] - Neoplasms [C04]
Gender: Female, Male. Age: 18-64 years, 65+ years. Enrolment: 18.
Status: Ended. Start date (EU): 2025-03-20. End date (EU): 2026-04-07. End date: 2026-04-08. Decision date: 2024-09-11. Results received: No. Last updated: 2026-02-24.

Condition(s): Metastatic or advanced malignant solid tumors

Source: https://euclinicaltrials.eu/ctis-public/view/2024-513563-75-00